EU clinical trial 2022-502345-10-00: The effect of oral folinic acid rescue therapy on pemetrexed induced neutropenia and other toxicity: A randomized open-label trial.
Sponsor: Amphia Hospital (Hospital/Clinic/Other health care facility). Phase: Therapeutic use (Phase IV). Countries: Netherlands (ended).
Therapeutic area(s): Diseases [C] - Respiratory Tract Diseases [C08]; Diseases [C] - Neoplasms [C04]
Gender: Female, Male. Age: 18-64 years, 65+ years. Enrolment: 50.
Status: Ended. Start date (EU): 2023-02-05. End date (EU): 2024-09-04. Decision date: 2023-01-18. Results received: Yes. Last updated: 2023-03-13.

Condition(s): Non small cell lung cancer (NSCLC), Mesothelioma, Thymoma
Product: Rescuvolin 15 mg, tabletten

Primary endpoint: Difference in neutrophil count (*109/L) at day 8-10.
Endpoint(s): Grade neutropenia (according to the CTCAE version 5, 2017) at day 8-10, Homocysteine plasma levels at baseline (μmol/L), Efficacy based on response CT after cycle 2 and 4 (categorical: response, partial response, progression), Incidence of discontinuation, dose delays and dose reductions.

Source: https://euclinicaltrials.eu/ctis-public/view/2022-502345-10-00